EU clinical trial 2024-514003-33-00: Randomised phase III, partly blinded study comparing the efficacy and safety of clobetasol, mometasone and tacrolimus in the treatment of lichen sclerosus of the vulva in a paediatric population.
Protocol code: 2023/ABM/01/00020
Sponsor: Uniwersytet Medyczny W Lublinie (Educational Institution). Phase: Therapeutic confirmatory (Phase III). Countries: Poland (ongoing, recruiting).
Therapeutic area(s): Diseases [C] - Female Urogenital Diseases and Pregnancy Complications [C13]
Gender: Female. Age: 0-17 years, 18-64 years. Enrolment: 93.
Status: Ongoing, recruiting. Start date (EU): 2025-12-29. Decision date: 2025-04-27. Results received: No. Last updated: 2026-02-10.

Condition(s): Patients with clinically diagnosed lichen sclerosus of the vulva.
Product: TACROLIMUS, MOMETASONE FUROATE, CLOBETASOL PROPIONATE

Primary endpoint: Evaluation of treatment efficacy, assessed as the percentage of patients with significant clinical improvement after 12 weeks, defined as achieving a minimum 75% reduction in subjective and physical symptoms physical symptoms and achieving a minimum of 50% improvement in quality of life from the baseline for arms I, II and III., Determining the safety of treatment for arms I, II and III.
Endpoint(s): A comparison of treatment efficacy, assessed as the percentage of patients with complete remission after 12 weeks, defined as the complete absence of subjective and physical symptoms vs. to baseline between arms I, II and III., Comparison of the effectiveness of maintaining the treatment effect assessed as a percentage of patients with a significant one clinical improvement 15 months after starting treatment, defined as maintaining 75% reduction of signs and symptoms and improvement of quality of life in relation to values initial between arms I, II and III., Assessment of the impact of demographic, immunological, microbiota and selected gene expression factors on the effectiveness of treatment for regimens I, II and III.

Source: https://euclinicaltrials.eu/ctis-public/view/2024-514003-33-00